EU clinical trial 2024-513191-17-00: API-AHAI - Efficacy of Prolonged Anticoagulation for Primary Prevention of Venous Thromboembolic Disease in Autoimmune Hemolytic Anemia: a Prospective, Phase II, Randomized, Multicenter Study
Sponsor: Centre Hospitalier Universitaire De Dijon (Hospital/Clinic/Other health care facility). Phase: Therapeutic exploratory (Phase II). Countries: France (ongoing, recruiting).
Therapeutic area(s): Diseases [C] - Immune System Diseases [C20]
Gender: Female, Male. Age: 18-64 years, 65+ years. Enrolment: 72.
Status: Ongoing, recruiting. Start date (EU): 2022-02-03. Decision date: 2024-07-15. Results received: No. Last updated: 2025-12-15.

Condition(s): autoimmune hemolytic anemia
Product: Eliquis 2.5 mg film-coated tablets, ENOXAPARIN SODIUM

Primary endpoint: Occurrence of clinical venous thromboembolic events (deep vein thrombosis (DVT) and pulmonary embolism (PE)) within 24 weeks of randomization defined by the presence of DVT confirmed by venous Doppler and/or PE confirmed by thoracic CT angiography or ventilation/perfusion lung scintigraphy.
Endpoint(s): Time to onset of venous thromboembolic events within 24 weeks of AIHA diagnosis or relapse, Occurrence of AE and SAE:Occurrence of a major hemorrhagic event, defined by the ISTH as clinically significant acute bleeding associated with one or more of the following: decrease in hemoglobin level of more than 2 g/dL or transfusion of at least 2 packed red blood cells (provided transfusion is not justified by AIHA), hemorrhage at a critical site (cerebral, spinal cord, retroperitoneal, intraocular, muscular with compartment syndrome, pericardial) or resulting in death, Occurrence of AE and SAE: Clinically significant non-major bleeding, defined as bleeding which does not meet the criteria for a major bleeding event, but which requires either medical attention or unscheduled medical contact (consultation or telephone), or which necessitates transient or permanent discontinuation of treatment, or which is responsible for discomfort or a reduction in the patient's quality of life., Occurrence of AE and SAE: Minor bleeding defined as any bleeding that does not meet the criteria for major or clinically significant non-major bleeding., Occurrence of AE and SAE: Any major cardiovascular event, whether fatal or not, Occurrence of AE and SAE: Other adverse events: splanchnic venous thrombosis, Occurrence of death, Determination of biological factors that may contribute to or be correlated with thromboembolic risk (D-dimer, sCD163, plasma hemoglobin, NETose, etc.)

Source: https://euclinicaltrials.eu/ctis-public/view/2024-513191-17-00